EU clinical trial 2023-503722-39-00: Bioequivalence study on aqueous humour concentrations of active ingredients after topical application of LEVIOSA® versus F2904. Randomized, parallel-group, blinded-assessor study in patients undergoing cataract surgery – BreAK Free
Protocol code: LevodesaPF_01-2023
Sponsor: Ntc S.r.l. (Pharmaceutical company). Phase: Human Pharmacology (Phase I)- Bioequivalence Study. Countries: Italy (ended).
Therapeutic area(s): Diseases [C] - Eye Diseases [C11]
Gender: Female, Male. Age: 18-64 years, 65+ years. Enrolment: 90.
Status: Ended. Start date (EU): 2024-04-22. End date (EU): 2025-03-20. Decision date: 2024-02-09. Results received: No. Last updated: 2024-12-19.

Condition(s): Cataract

Source: https://euclinicaltrials.eu/ctis-public/view/2023-503722-39-00